EU clinical trial 2023-504720-26-00: A Single-dose, Open-label, Randomized, Crossover Study to Assess the Relative Oral Bioavailability of a JNJ-77242113 Phase 3 Immediate-release Tablet Formulation with Respect to the Phase 2 Immediate-release Tablet Formulation and to Assess the Food Effect of a JNJ-77242113 Phase 3 Immediate-release Tablet Formulation in Healthy Participants
Sponsor: Janssen - Cilag International (Pharmaceutical company). Phase: Human Pharmacology (Phase I)- Other. Countries: Belgium (ended).
Therapeutic area(s): Diseases [C] - Immune System Diseases [C20]
Gender: Female, Male. Age: 18-64 years. Enrolment: 24.
Status: Ended. Start date (EU): 2023-07-19. End date (EU): 2023-09-11. Decision date: 2023-06-28. Results received: Yes. Last updated: 2023-06-28.

Condition(s): Inflammatory Conditions
Product: JNJ-77242113, JNJ-77242113

Primary endpoint: Area under the plasma analyte concentration-time curve (AUC) from time 0 to time of the last measurable concentration (AUClast), AUC from time 0 to infinite time (AUC∞), and maximum observed plasma analyte concentration (Cmax) after a single oral dose of the Phase 3 IR vs the Phase 2 IR tablet.

Source: https://euclinicaltrials.eu/ctis-public/view/2023-504720-26-00